EU clinical trial 2022-502117-29-00: Standard versus Prolonged Neoadjuvant (Conversion) Chemotherapy to prolong survival of patients with Borderline and Locally Advanced Pancreatic Cancer: a phase III randomized controlled trial
Sponsor: Vastra Gotalandsregionen (Hospital/Clinic/Other health care facility). Phase: Therapeutic confirmatory (Phase III). Countries: Sweden (ongoing, recruiting), Germany (authorised, recruitment pending).
Therapeutic area(s): Diseases [C] - Digestive System Diseases [C06]; Diseases [C] - Neoplasms [C04]
Gender: Female, Male. Age: 18-64 years, 65+ years. Enrolment: 754.
Start date (EU): 2023-10-19. Decision date: 2023-02-20. Results received: No. Last updated: 2026-06-22.
Decision dates by country: SE: 2023-02-20, DE: 2025-11-25

Condition(s): Advanced pancreatic cancer
Product: Kalciumfolinat STADA 10 mg/ml injektionsvätska, lösning, Gemcitabine Accord 100 mg/ml Koncentrat till infusionsvätska, lösning, Irinotecan Hydrochloride 20 mg/ml concentrate for solution for infusion, Oxaliplatin Hospira 5 mg/ml concentrate for solution for infusion, Paclitaxel 6 mg/ml concentrate for solution for infusion, Fluorouracil 50mg/ml Injection.

Primary endpoint: • Overall survival at 24 months after randomization • Overall survival among resected patients at 24 months after randomization
Endpoint(s): • Overall survival in intention-to-treat and per protocol treated • Progression-free survival • Overall survival among non-resected at 24 months • Overall survival among patients with BR in the two arms and among patients with LAPC in the two arms in ITT • Overall and progression-free survival among resected patients with BR in the two arms and among resected patients with LAPC in the two arms • Difference in overall and progression-free survival between BR and LAPC patients – in ITT among al

Source: https://euclinicaltrials.eu/ctis-public/view/2022-502117-29-00